EU clinical trial 2024-517838-17-00: Bioavailability study with naloxone hydrochloride in healthy volunteers
Protocol code: CVP24001
Sponsor: CCDRD Cooperative Clinical Drug Research and Development AG, Vaccpower Limited (Pharmaceutical company). Phase: Human Pharmacology (Phase I)- Bioequivalence Study. Countries: Bulgaria (ended).
Therapeutic area(s): Psychiatry and Psychology [F] - Behavior and Behavior Mechanisms [F01]
Gender: Female, Male. Age: 18-64 years. Enrolment: 14.
Status: Ended. Start date (EU): 2026-03-06. End date (EU): 2026-03-16. Decision date: 2026-02-10. Results received: No. Last updated: 2026-02-10.

Condition(s): No therapeutic indication in the current trial with healthy volunteers.

Source: https://euclinicaltrials.eu/ctis-public/view/2024-517838-17-00